EU clinical trial 2024-515283-31-00: An open label, multi-center, Phase IV rollover protocol for patients who have completed a prior global Novartis or Incyte sponsored ruxolitinib (INC424) study or a study of ruxolitinib in combination with either panobinostat (LBH589) or siremadlin (HDM201) or rineterkib (LTT462), and are judged by the investigator to benefit from continued treatment
Protocol code: CINC424A2X01B
Sponsor: Novartis Pharma Services AG (Pharmaceutical company). Phase: Therapeutic use (Phase IV). Countries: Germany (ongoing, recruitment ended), Italy (ongoing, recruitment ended), Sweden (ongoing, recruitment ended), Poland (ongoing, recruitment ended).
Therapeutic area(s): Diseases [C] - Neoplasms [C04]
Gender: Female, Male. Age: 0-17 years, 18-64 years, 65+ years. Enrolment: 33.
Status: Ongoing, recruitment ended. Start date (EU): 2015-07-30. Decision date: 2024-09-11. Results received: No. Last updated: 2026-05-08.
Decision dates by country: IT: 2024-09-16, PL: 2024-10-16, SE: 2024-09-11, DE: 2024-09-17

Condition(s): This study is designed to accept patients with varied disease origins, depending on the parent protocol
Product: Jakavi 5 mg tablets, Jakavi 10 mg tablets, Jakavi 15 mg tablets, Jakavi 20 mg tablets, Jakavi 5 mg tablets, HDM201, RUXOLITINIB, Jakavi 20 mg tablets, Farydak 15 mg hard capsules, Jakavi 10 mg tablets, Jakavi 15 mg tablets, Jakavi 5 mg tablets, Farydak 10 mg hard capsules, Jakavi 10 mg tablets, Jakavi 15 mg tablets, HDM201, Jakavi 20 mg tablets

Primary endpoint: Frequency and severity of SAEs/AEs
Endpoint(s): Proportion of patients with clinical benefit as assessed by the investigator at scheduled visits, Frequency and severity of AEs / SAEs, Proportion of patients with clinical benefit and assessed by the investigators at scheduled visits

Source: https://euclinicaltrials.eu/ctis-public/view/2024-515283-31-00